EU clinical trial 2023-510085-27-00: SPondyloArthritis: inducing drug-free Remission by early TNF-Alpha bloCkade Under guidance of Single cell RNA sequencing and epigenetic profiling (SPARTACUS).
Protocol code: SPARTACUS
Sponsor: Universitair Ziekenhuis Gent (Hospital/Clinic/Other health care facility). Phase: Therapeutic confirmatory (Phase III). Countries: Belgium (ongoing, recruitment ended).
Therapeutic area(s): Diseases [C] - Musculoskeletal Diseases [C05]
Gender: Female, Male. Age: 18-64 years, 65+ years. Enrolment: 150.
Status: Ongoing, recruitment ended. Start date (EU): 2020-08-21. Decision date: 2024-09-02. Results received: No. Last updated: 2025-06-10.

Condition(s): Peripheral Spondyloarthritis
Product: Simponi 50 mg solution for injection in pre-filled syringe., Simponi 50 mg solution for injection in pre-filled pen., Simponi 50 mg solution for injection in pre-filled syringe., The Placebo product (with the exception of the active substance), is manufactured by the same manufacturer, as the Golimumab Blinded IMP and is not sterile., Placebo Ledertrexate, Ledertrexate 2,5 mg Tabletten, Simponi 50 mg solution for injection in pre-filled syringe., LEDERTREXATE 2,5 mg tabletten, LEDERTREXATE 2,5 mg comprimés, Simponi 50 mg solution for injection in pre-filled pen., Simponi 50 mg solution for injection in pre-filled pen., Simponi 50 mg solution for injection in pre-filled syringe., Simponi 50 mg solution for injection in pre-filled pen.

Primary endpoint: Proportion of patients achieving clinical remission.
Endpoint(s): Comparison between the "TNFi induction" group and the "csDMARD Step-up" group regarding:Achievement of "sustained clinical remission" at week 24 (and week 36 for the patients remaining on blinded study medication)., Comparison between the "TNFi induction" group and the "csDMARD Step-up" group regarding:Improvement from baseline to week 12 and 24 in individual clinical assessments (78-Tender Joint Count, 76-Swollen Joint Count, Dactylitis Count, SPARCC Enthesitis Score) and composite scores (ASDAS: Axial Spondyloarthritis Disease Activity Score)., Comparison between the "TNFi induction" group and the "csDMARD Step-up" group regarding:Improvement from baseline to week 12 and 24 in patient-reported outcomes (Patient global assessment of disease activity and pain, BASDAI, BASFI, ASAS Health Index., Comparison between the "TNFi induction" group and the "csDMARD Step-up" group regarding:Improvement from baseline to week 12 and 24 in inflammatory parameters (ESR, CRP)., Comparison between the "TNFi induction" group and the "csDMARD Step-up" group regarding:Changes in concomitant NSAID intake (NSAID-index) and "escape" intra-articular glucocorticoid injections between baseline and week 24., Difference in occurrence of (serious) adverse events (AEs) and AEs of specific interest between the 2 treatment strategies from baseline to week 24 (and week 36 for patients remaining on blinded study medication). Descriptive analysis of the number and type of adverse events between both strategies, Percentage of patients achieving (sustained) clinical remission with open-label golimumab treatment after failure of the initial randomized, blinded treatment strategy. Exploration of difference in percentage of patients that reach (sustained) clinical remission according to symptom duration (<3 months versus ≥3 month and <12 months).

Source: https://euclinicaltrials.eu/ctis-public/view/2023-510085-27-00